EU clinical trial 2024-512279-10-00: A Randomized, Open-label, Phase 3 Study of Adjuvant Sacituzumab Govitecan and Pembrolizumab Versus Treatment of Physician’s Choice in Patients With Triple Negative Breast Cancer Who Have Residual Invasive Disease After Surgery and Neoadjuvant Therapy
Protocol code: GS-US-595-6184
Sponsor: Gilead Sciences Inc. (Pharmaceutical company). Phase: Therapeutic confirmatory (Phase III). Countries: Germany (ongoing, recruiting), Ireland (ongoing, recruiting), Spain (ongoing, recruiting), France (ongoing, recruiting), Belgium (ongoing, recruiting), Italy (ongoing, recruiting).
Therapeutic area(s): Diseases [C] - Neoplasms [C04]
Gender: Female. Age: 18-64 years, 65+ years. Enrolment: 781.
Status: Ongoing, recruiting. Start date (EU): 2024-11-25. Decision date: 2024-10-22. Results received: No. Last updated: 2026-07-23.
Decision dates by country: BE: 2025-09-04, ES: 2025-01-13, FR: 2025-03-06, DE: 2024-10-22, IT: 2025-09-11, IE: 2024-12-05

Condition(s): Triple Negative Breast Cancer
Product: KEYTRUDA 25 mg/mL concentrate for solution for infusion, Xeloda 500 mg film-coated tablets, Trodelvy 200 mg powder for concentrate for solution for infusion

Primary endpoint: iDFS is defined as the time from the date of randomization to death from any cause or one of the following events (whichever occurs first): invasive local, regional, or distant recurrence, or invasive contralateral breast cancer.
Endpoint(s): OS is defined as the time from the date of randomization until death due to any cause., dDFS is defined as the time from the date of randomization to death from any cause or one of the following events (whichever occurs first): distant recurrence, or second primary invasive cancer., RFS is defined as the time from the date of randomization to death from any cause or one of the following events (whichever occurs first): invasive local, regional, or distant recurrence, Incidence of TEAEs and clinical laboratory abnormalities, TTW of QoL based on FACT-B Trial Outcome Index (TOI) score

Source: https://euclinicaltrials.eu/ctis-public/view/2024-512279-10-00